EU clinical trial 2024-510752-12-00: General anesthesia versus sedation with high-flow nasal cannula for the endovascular treatment of acute ischemic stroke. GHIFTS Study (General anesthesia vs High Flow nasal cannula for Thrombectomy on Stroke)
Protocol code: GHIFTS
Sponsor: Hospital Universitario La Paz (Hospital/Clinic/Other health care facility). Phase: Therapeutic use (Phase IV). Countries: Spain (ongoing, recruiting).
Therapeutic area(s): Analytical, Diagnostic and Therapeutic Techniques and Equipment [E] - Anesthesia and Analgesia [E03]
Gender: Female, Male. Age: 18-64 years, 65+ years. Enrolment: 116.
Status: Ongoing, recruiting. Start date (EU): 2024-11-13. Decision date: 2024-08-14. Results received: No. Last updated: 2024-09-10.

Condition(s): Acute ischemic stroke
Product: Lidocaína B. Braun 10 mg/ml solución inyectable, Fentanest 0,05 mg/ml solución inyectable, Propofol Fresenius 10 mg/ml emulsión para inyección o perfusión, Esmeron 10 mg/ml solución inyectable y para perfusión, Aire medicinal sintético Carburos Metálicos, 22% v/v, gas medicinal, comprimido

Primary endpoint: Time between arrival at the hospital door and arterial recanalization (in minutes). This time has been shown to be sensitive to the type of anesthetic procedure used in the different meta-analyses published and, in addition to including the time of the intervention, which may also be influenced by the anesthetic technique, it is less affected by other factors than other times collected for the assessment of stroke treatment, such as the time from onset of the clinic to recanalization.
Endpoint(s): NIHSS scale at 24 hours and the modified Rankin scale (mRS) 90 days after stroke., Door time - arterial puncture: minutes. Arterial puncture time - recanalization: minutes, Degree of arterial recanalization, according to the mTICI scale (modified Thrombolysis in Cerebral Infarction Scale): 0-3, Incidence of complications during the intervention in both groups (arterial perforation, dissection, embolisms to new territories, complications at the point of arterial puncture, arterial hypertension or hypotension, arrhythmias, hypoxemia, and bronchial aspiration) as well as after the procedure (cerebral hemorrhage, hypertension or hypotension, arrhythmias, hypoxemia or pneumonia). Their presence will be assessed after 24 hours, and upon discharge from hospital.

Source: https://euclinicaltrials.eu/ctis-public/view/2024-510752-12-00